EU clinical trial 2024-519354-36-00: Continuing ovulation induction with letrozole versus switching to gonadotropins in women with polycystic ovary syndrome (MOVIN-II study)
Sponsor: Amsterdam UMC Stichting (Patient organisation/association). Phase: Therapeutic use (Phase IV). Countries: Netherlands (ongoing, recruiting).
Therapeutic area(s): Diseases [C] - Female Urogenital Diseases and Pregnancy Complications [C13]; Phenomena and Processes [G] - Reproductive and Urinary Physiological Phenomena [G08]; Health Care [N] - Environment and Public Health [N06]; Analytical, Diagnostic and Therapeutic Techniques and Equipment [E] - Therapeutics [E02]; Health Care [N] - Health Care Economics and Organizations [N03]
Gender: Female. Age: 18-64 years. Enrolment: 816.
Status: Ongoing, recruiting. Start date (EU): 2025-08-01. Decision date: 2025-05-30. Results received: No. Last updated: 2026-05-13.

Condition(s): Polycystic ovary syndrome (PCOS)
Product: LETROZOLE, HUMAN MENOPAUSAL GONADOTROPHINS, FOLLITROPIN ALFA

Primary endpoint: Pregnancy within 8 months after randomization, leading to a live birth
Endpoint(s): Clinical pregnancy, ongoing pregnancy, biochemical pregnancy loss and miscarriage rates within 8 months after randomisation, For each participant, the number of treatment cycles initiated, completed and cancelled are evaluated within 8 months after randomisation, Of all achieved (ongoing) pregnancies occurring within 8 months after randomization (including spontaneous pregnancies) the following outcomes are assessed; multiple pregnancy rate, time to pregnancy, pregnancy complications, perinatal outcomes, type of delivery and outcomes, Side effects, compliance and smoking behavior during treatment assessed through telephone appointment and questionnaires sent out at 3 months and 8 months after randomisation., Quality of life and mental health assessed at time of randomization, and at 3 months and 8 months after randomization, using the PCOS-QoL questionnaire and the HADS questionnaire, Budget impact and cost-effectiveness analyses using live birth rates

Source: https://euclinicaltrials.eu/ctis-public/view/2024-519354-36-00